EU clinical trial 2025-522611-42-00: Long Covid (LC)-Revitalize - A Long Covid Repurposed Drug Study
Protocol code: LC-Revitalize
Sponsor: Dr. Douglas D. Fraser (Pharmaceutical company). Phase: Therapeutic confirmatory (Phase III). Countries: Italy (not authorised).
Therapeutic area(s): Diseases [C] - Virus Diseases [C02]
Gender: Female, Male. Age: 18-64 years. Enrolment: 75.
Status: Not authorised. Decision date: 2026-02-25. Results received: No. Last updated: 2026-02-25.

Condition(s): Long Covid
Product: CELLULOSE, MICROCRYSTALLINE, CELLULOSE, MICROCRYSTALLINE, RINVOQ 15 mg prolonged-release tablets, Placebo for Pirfenidone, Pirfenidon Accord 267 mg Filmtabletten, Placebo for Upadacitinib

Primary endpoint: The aim of this study is to evaluate the efficacy of two repurposed drugs in reducing symptom severity in participants with Long Covid. The change in symptom score (transformed scale of 0-100) from baseline to both the interim and final analyses will be compared across one of the five validate subscales, relative to the placebo. This study will utilize five validated subscales: 1) Fatigue, 2) Breathing, 3) Memory, Thinking, and Communication, 4) Muscles and Joints, and 5) Circulation.
Endpoint(s): To compare symptom burden of participants with Long Covid treated with study drug versus placebo by measuring the change in total scores of the Patient Reported Outcome Measurement Information System (PROMIS)-29 questionnaire., To compare symptom burden of participants with Long Covid treated with study drug versus placebo by measuring the change in total scores of the Generalized Anxiety Disorder (GAD)-7 questionnaire from baseline to the interim and final analyses., To compare symptom burden of participants with Long Covid treated with study drug versus placebo by measuring the change in total scores of the Patient Health Questionnaire (PHQ)-9 from baseline to the interim and final analyses. The PHQ-9 questionnaire consists of 9 items related to the symptoms of depression. Each item is scored on a scale of 0-3 with higher scores indicating more severe symptoms., To assess whether symptom burden worsens in participants with Long Covid treated with study drugs versus placebo, specifically when symptoms are reported across multiple scales indicated by the total number of participants with increased SBQ subscale scores. The following SBQ subscales will be used during this study: 1) Fatigue, 2) Breathing, 3) Memory, thinking, and communication, 4) Muscles and joints, 5) Circulation., To measure specific pathophysiological biomarker of study drugs versus placebo indicated by the normalization of blood biomarkers after treatment in picograms per milliliter (pg/mL)., To assess changes in exercise capacity over time of participants with Long Covid treated with study drugs versus placebo. The score is determined by the distance a participant walks in six minutes around the perimeter of a designated circuit., The frequency and severity of adverse events and laboratory abnormalities will be monitored to assess safety and tolerability. A lower incidence and severity will indicate that the drugs are safer and more tolerable., Plasma proteomics will be analyzed to assess protein differential expression and signaling pathway mechanisms related to the study drugs. Analyses will focus on the expression normalization of proteins/pathways associated with Long Covid. Plasma metabolomics will be analyzed to evaluate metabolic changes and the overall effects of the study drugs. Analyses will focus on the concentration normalization of metabolites linked to the pathophysiology of Long Covid.

Source: https://euclinicaltrials.eu/ctis-public/view/2025-522611-42-00